EU clinical trial 2023-506564-14-00: A Trial to Determine the Safety of CC-93269, an Antibody, in People who have Multiple Myeloma That Has Returned After a Period of Treatment And is not Responsive After Treatment.
Protocol code: CC-93269-MM-001
Sponsor: Celgene International II S.a.r.l. (Pharmaceutical company). Phase: Human Pharmacology (Phase I)- First administration to humans. Countries: Spain (ended), Germany (ended), Sweden (ended), Italy (ended).
Therapeutic area(s): Diseases [C] - Neoplasms [C04]
Gender: Female, Male. Age: 18-64 years, 65+ years. Enrolment: 112.
Status: Ended. Start date (EU): 2018-05-16. End date (EU): 2025-01-15. End date: 2025-03-18. Decision date: 2023-10-06. Results received: No. Last updated: 2025-04-22.
Decision dates by country: SE: 2023-10-10, IT: 2023-11-17, ES: 2023-10-06, DE: 2023-10-11

Condition(s): Relapsed and refractory multiple myeloma (RRMM)

Source: https://euclinicaltrials.eu/ctis-public/view/2023-506564-14-00